EU clinical trial 2024-516897-31-00: Double-blind, randomised, prospective, placebo controlled parallel group phase II study to investigate the effect of glycerol phenylbutyrate (GPB) on neurofilament light chain (NfL) levels in patients with corticobasal syndrome (CBS)
Protocol code: PROFIL-2088-SIM-0032
Sponsor: Klinikum der Technischen Universitaet Muenchen (TUM Klinikum) (Hospital/Clinic/Other health care facility). Phase: Therapeutic exploratory (Phase II). Countries: Germany (ongoing, recruitment ended).
Therapeutic area(s): Diseases [C] - Nervous System Diseases [C10]
Gender: Female, Male. Age: 18-64 years, 65+ years. Enrolment: 32.
Status: Ongoing, recruitment ended. Start date (EU): 2023-12-01. Decision date: 2024-09-26. Results received: No. Last updated: 2026-05-08.

Condition(s): Corticobasal Syndrome (CBS)
Product: RAVICTI 1.1 g/ml oral liquid, hydroxypropyl methylcellulose HPMC 4000, sodium benzoate, propylene glycole, aqua destillata

Primary endpoint: Primary efficacy endpoint: The primary outcome measure will be the longitudinal change of NfL in plasma between V1 and V3 comparing GPB vs. Placebo-treated patients., Safety: Incidence of ARs, Safety laboratory evaluation (basic clinical chemistry), Vital signs (blood pressure, heart rate, temperature), Physical and neurological examination, Survival time and survival rate during the study period, Tolerability: Number of subjects (and % of the intention-to-treat population), who discontinue the clinical trial due to adverse reactions
Endpoint(s): Longitudinal changes in clinical scales (MDS-UPDRS Part III, PSP-RS, PSP-CDS, CBFS, DATE, MoCA, SEADL, CGI-s, PSP-QoL) between V1 and V3 comparing placebo- vs. verum-treated patients

Source: https://euclinicaltrials.eu/ctis-public/view/2024-516897-31-00